EU clinical trial 2024-514328-18-00: A phase 1/2a, open-label trial to investigate the safety, tolerability, pharmacokinetics and pharmacodynamics of multiple ascending doses of intrathecally administered VO659 in participants with spinocerebellar ataxia types 1, 3 and Huntington’s disease
Protocol code: VO659-CT01
Sponsor: Vico Therapeutics B.V. (Pharmaceutical company). Phase: Phase I and Phase II (Integrated)- First administration to humans. Countries: Netherlands (ongoing, recruiting), Denmark (ongoing, recruiting), France (ongoing, recruiting), Germany (ongoing, recruiting).
Therapeutic area(s): Diseases [C] - Nervous System Diseases [C10]
Gender: Female, Male. Age: 18-64 years. Enrolment: 88.
Status: Ongoing, recruiting. Start date (EU): 2022-12-06. Decision date: 2024-11-11. Results received: No. Last updated: 2026-05-13.
Decision dates by country: DK: 2024-11-11, NL: 2024-11-12, FR: 2024-11-15, DE: 2024-11-11

Condition(s): Spinocerebellar ataxia types 1, 3 and Huntington's disease
Product: VO659

Primary endpoint: • Incidence and dose relationships of treatment-related: o AEs, o SAEs, o AESI o Severe events (NCI- CTCAE Grade 3 or higher)., • Changes in clinical safety parameters including physical and neurological examinations, vital signs, body weight, ECG, cardiac monitoring, suicidal ideation and behaviour risk monitoring by the C-SSRS, and review of structural MRI scans, • Changes in laboratory safety parameters in blood (haematology, haemostasis, and clinical chemistry), CSF (cell counts, protein, and glucose), and urine (urinalysis), • Adverse changes in clinical status based on exploratory clinical, biochemical and neuroimaging assessments
Endpoint(s): • The CSF concentration-time profile of VO659, including the derived PK parameter of elimination t1/2, if possible, • The plasma concentration-time profile of VO659, including the derived PK parameters such as the area under the curve, peak plasma concentration t1/2.

Source: https://euclinicaltrials.eu/ctis-public/view/2024-514328-18-00